EU clinical trial 2025-524110-28-00: Pulmonary Embolism & Anticoagulation Evaluation in Cancer Patient - PEACE
Protocol code: PEACE
Sponsor: Region Hovedstaden (Hospital/Clinic/Other health care facility). Phase: Therapeutic use (Phase IV). Countries: Denmark (authorised, recruitment pending).
Therapeutic area(s): Diseases [C] - Cardiovascular Diseases [C14]; Diseases [C] - Neoplasms [C04]
Gender: Female, Male. Age: 18-64 years, 65+ years. Enrolment: 234.
Status: Authorised, recruitment pending. Decision date: 2026-06-04. Results received: No. Last updated: 2026-06-04.

Condition(s): Incidental Subsegmental Pulmonary Embolism in cancer patients
Product: EDOXABAN, DALTEPARIN, TINZAPARIN, APIXABAN, ENOXAPARIN, RIVAROXABAN

Primary endpoint: WIN ratio of a composite hierarchical endpoint assessed over follow-up including: 1) all-cause mortality 2) clinical pulmonary embolism verified by imaging 3) major bleeding as defined by the International Society on Thrombosis and Haemostasis 4) clinically relevant non-major bleeding as defined by the International Society on Thrombosis and Haemostasis
Endpoint(s): Clinically relevant bleeding (major bleeding + CRNMB based on the ISTH- definition), Venous thromboembolism other than pulmonary embolism verified by imaging, Progression, stability or resolution of thrombosis on imaging, assessed by two independent radiologists, Discontinuation of cancer treatment related to pulmonary embolism or pulmonary embolism treatment, Quality of life assessed by the EuroQol 5-Dimension 5-level (EQ-5D-5L), pulmonary embolism quality of life questionnaire (PEmb-QoL) and the European Organisation for Research and Treatment of Cancer quality of life questionnaire (EORTC QLQ C30)

Source: https://euclinicaltrials.eu/ctis-public/view/2025-524110-28-00